EU clinical trial 2024-513284-30-00: A Phase 1b Trial of ARV-471 in Combination with Everolimus in Patients with ER+, HER2– Advanced or Metastatic Breast Cancer
Protocol code: ARV-471-mBC-102
Sponsor: Arvinas Estrogen Receptor Inc. (Pharmaceutical company). Phase: Human Pharmacology (Phase I)- Other. Countries: Spain (ended).
Therapeutic area(s): Diseases [C] - Neoplasms [C04]
Gender: Female, Male. Age: 18-64 years, 65+ years. Enrolment: 1.
Status: Ended. Start date (EU): 2023-03-22. End date (EU): 2025-08-25. End date: 2025-08-26. Decision date: 2024-07-17. Results received: No. Last updated: 2025-02-13.

Condition(s): ER+, HER2– Advanced or Metastatic Breast Cancer
Product: Everolimus Zentiva 2,5 mg Tabletten, PF-07850327 round, Everolimus Zentiva 5 mg Tabletten, ARV-471

Primary endpoint: First-cycle DLTs and determination of a RP2D., Adverse events as characterized by type, frequency, severity (as graded by NCI CTCAE version 5.0), timing, seriousness, and relationship to study drug combination., Laboratory abnormalities as characterized by type, frequency, severity (as graded by NCI CTCAE version 5.0), and timing.
Endpoint(s): ORR by Investigator per RECIST v1.1 in patients with measurable disease at baseline., CBR by Investigator (includes all CRs, all PRs, and SD lasting at least 24 weeks)., DOR., PK parameters

Source: https://euclinicaltrials.eu/ctis-public/view/2024-513284-30-00